EU clinical trial 2024-517437-40-00: Patient reported efficacy of intranasal lysine-aspirin in controlling NSAID-exacerbated respiratory disease.
Protocol code: S67072
Sponsor: UZ Leuven (Hospital/Clinic/Other health care facility). Phase: Therapeutic exploratory (Phase II). Countries: Belgium (ended).
Therapeutic area(s): Diseases [C] - Otorhinolaryngologic Diseases [C09]
Gender: Female, Male. Age: 18-64 years, 65+ years. Enrolment: 30.
Status: Ended. Start date (EU): 2022-11-15. End date (EU): 2026-03-11. Decision date: 2024-10-25. Results received: Yes. Last updated: 2024-10-25.

Condition(s): Nonsteroidal anti-inflammatory drug Exacerbated Respiratory Disease (N-ERD)
Product: MINI-PLASCO NACL B. BRAUN 0,9 %, solution injectable, ACETYLSALICYLIC ACID

Primary endpoint: Change from baseline in VAS for rhinosinusitis and asthma severity, Change from baseline in NC score, Change from baseline in ACQ-6 score, Change from baseline in SNOT-22 score, Change from baseline in AQLQ(S), Change from baseline in PGIC, Change from baseline in sQODNS score, Change from baseline in EQ-5D-5L, Change from baseline in provoking dose, Proportion of patients with serious and non-serious adverse events related to gastro-intestinal disturbance (nausea, vomiting, diarrhoea, abdominal pain)
Endpoint(s): Change from baseline in PNIF, Change from baseline in smell score (UPSIT), Change from baseline in FEV1, Change from baseline in FeNO and nNO, Change from baseline in NPS, Proportion of patients who have or are planned for surgery of nasal polyps, as well as time-to-event, Proportion of patients with OCS use for chronic rhinosinusitis/asthma exacerbation, as well as time to first course, number of courses, total dose used, total duration, Dosage (dose and frequency) of inhaled/intranasal corticosteroids, reported as dosage during desensitisation and dosage during maintenance therapy (after goal of escalation is reached)

Source: https://euclinicaltrials.eu/ctis-public/view/2024-517437-40-00